EU clinical trial 2024-518450-16-00: Public title :A Phase 1b/2a trial to evaluate Invobenitug also known as Procizumab (PCZ; AK1967) in critical cardiovascular care.
Protocol code: CT-P1-002
Sponsor: 4TEEN4 Pharmaceuticals GmbH (Pharmaceutical company). Phase: Phase I and Phase II (Integrated)- Other. Countries: France (temporarily halted), Czechia (temporarily halted), Netherlands (temporarily halted), Belgium (temporarily halted), Poland (temporarily halted), Germany (authorised, recruitment pending).
Therapeutic area(s): Diseases [C] - Cardiovascular Diseases [C14]
Gender: Female, Male. Age: 18-64 years, 65+ years. Enrolment: 111.
Start date (EU): 2025-06-13. Decision date: 2025-04-08. Results received: No. Last updated: 2026-07-14.
Decision dates by country: FR: 2025-04-14, PL: 2025-04-14, NL: 2025-04-14, BE: 2025-04-08, CZ: 2025-04-09, DE: 2026-07-14

Condition(s): Cardiogenic shock due to Acute Coronary Syndrome, cardiogenic shock of septic origin or cardiogenic shock due to Acute decompensated Heart Failure

Source: https://euclinicaltrials.eu/ctis-public/view/2024-518450-16-00